EU clinical trial 2025-522113-35-00: A Phase 2a, Randomized, Multicenter, Double-Blind, Placebo-Controlled Study to Evaluate the Efficacy, Safety, and Pharmacokinetics of Multiple Subcutaneous Doses of TRIV-509 in Adults with Moderate to Severe Atopic Dermatitis
Protocol code: 509-101
Sponsor: Triveni Bio Inc. (Pharmaceutical company). Phase: Therapeutic exploratory (Phase II). Countries: Poland (ongoing, recruitment ended), Bulgaria (ongoing, recruitment ended), Czechia (ongoing, recruitment ended), Hungary (ongoing, recruitment ended).
Therapeutic area(s): Diseases [C] - Skin and Connective Tissue Diseases [C17]
Gender: Female, Male. Age: 18-64 years, 65+ years. Enrolment: 54.
Status: Ongoing, recruitment ended. Start date (EU): 2026-01-07. Decision date: 2025-12-09. Results received: No. Last updated: 2026-07-09.
Decision dates by country: BG: 2025-12-10, HU: 2025-12-15, PL: 2025-12-14, CZ: 2026-01-20

Condition(s): Atopic dermatitis
Product: TRIV-509, TRIV-509 Placebo (PRD12690501)

Primary endpoint: 1. Percentage of participants with improvement of AD at Week 16
Endpoint(s): 1. Percentage of participants with improvement of AD at Week 16 5. Percentage of participants with TEAEs 6. Percentage of participants with SAEs 7. Changes in vital signs, ECG parameters, and safety laboratory values 8. Single-dose and multiple-dose PK parameters 9. Percentage of participants with anti-TRIV-509 antibodies

Source: https://euclinicaltrials.eu/ctis-public/view/2025-522113-35-00